EU clinical trial 2023-507997-41-00: Evaluation of the effect of CHF6795 on the pharmacokinetics of midazolam, repaglinide and rosuvastatin in healthy subjects
Protocol code: CLI-06795AA1-09
Sponsor: Chiesi Farmaceutici S.p.A. (Pharmaceutical company). Phase: Human Pharmacology (Phase I)- Other. Countries: Belgium (ended).
Therapeutic area(s): Diseases [C] - Respiratory Tract Diseases [C08]
Gender: Female, Male. Age: 18-64 years. Enrolment: 24.
Status: Ended. Start date (EU): 2024-01-25. End date (EU): 2024-05-21. Decision date: 2024-01-22. Results received: No. Last updated: 2024-04-09.

Condition(s): Chronic cough

Source: https://euclinicaltrials.eu/ctis-public/view/2023-507997-41-00